EU clinical trial 2022-502923-23-00: First-in-human study of SAR445611 in healthy adult participants
Protocol code: SAD17732-MAD17733
Sponsor: Sanofi-Aventis Recherche & Developpement (Pharmaceutical company). Phase: Human Pharmacology (Phase I)- First administration to humans. Countries: Belgium (ended).
Therapeutic area(s): Diseases [C] - Immune System Diseases [C20]
Gender: Female, Male. Age: 18-64 years. Enrolment: 234.
Status: Ended. Start date (EU): 2023-06-12. End date (EU): 2024-08-07. Decision date: 2023-06-06. Results received: No. Last updated: 2024-05-14.

Condition(s): Immune system diseases

Source: https://euclinicaltrials.eu/ctis-public/view/2022-502923-23-00